EU clinical trial 2025-521397-34-00: Colchicine to reduce microvascular complications in people with type 1 diabetes and high glycemic variability
Protocol code: 116795
Sponsor: Radboud universitair medisch centrum Stichting (Hospital/Clinic/Other health care facility). Phase: Phase III and phase IV (Integrated). Countries: Netherlands (ongoing, recruiting).
Therapeutic area(s): Diseases [C] - Nutritional and Metabolic Diseases [C18]
Gender: Female, Male. Age: 18-64 years, 65+ years. Enrolment: 80.
Status: Ongoing, recruiting. Start date (EU): 2025-12-15. Decision date: 2025-10-13. Results received: No. Last updated: 2026-06-09.

Condition(s): Type 1 Diabetes
Product: Colchicine Teva 0,5 mg, tabletten, Capsules with microcrystalline cellulose

Primary endpoint: Changes in marker for (subclinical) diabetic retinopathy (vessel density on OCTA) during the study period
Endpoint(s): Changes in markers for (subclinical) diabetic retinopathy (e.g. micro-aneurysms, thinning of retinal layers, foveal avascular zone) during the study period, Changes in markers for (subclinical) diabetic nephropathy (plasma creatinine and urea, urinary microalbuminuria) during the study period, Changes in inflammatory parameters (e.g. circulating immune cell numbers and phenotypes, immune cell function, circulating inflammatory proteins including various pro-inflammatory cytokines, endothelial markers) during the study period, Changes in glycemic variability markers (e.g. coefficient of variation, time in range, standard deviation) as measured by the glucose sensor during the study period

Source: https://euclinicaltrials.eu/ctis-public/view/2025-521397-34-00